EU clinical trial 2024-512756-38-00: A Phase IIa, randomised, double-blind, placebo-controlled trial to evaluate the safety, efficacy, pharmacokinetics and pharmacodynamics of BI 706321 orally administered for 12 weeks in patients with Crohn`s Disease (CD) receiving ustekinumab induction treatment
Protocol code: 1425-0003
Sponsor: Boehringer Ingelheim International GmbH (Pharmaceutical company). Phase: Therapeutic exploratory (Phase II). Countries: Italy (ended), Spain (ended), Czechia (ended), Germany (ended), Poland (ended), Hungary (ended).
Therapeutic area(s): Diseases [C] - Digestive System Diseases [C06]
Gender: Female, Male. Age: 18-64 years, 65+ years. Enrolment: 27.
Status: Ended. Start date (EU): 2022-02-17. End date (EU): 2024-08-08. Decision date: 2024-07-18. Results received: Yes. Last updated: 2024-08-05.
Decision dates by country: CZ: 2024-07-23, DE: 2024-07-19, HU: 2024-07-18, IT: 2024-08-05, ES: 2024-07-22, PL: 2024-08-04

Condition(s): Crohn`s Disease (CD)
Product: Matching placebo tablets without active substance, BI 706321, BI 706321, BI 706321, STELARA 130 mg concentrate for solution for infusion, STELARA 90 mg solution for injection in pre-filled pen

Primary endpoint: Absolute change from baseline in Simple Endoscopic Score for Crohn's disease (SES-CD) at week 12.
Endpoint(s): Percent change in SES-CD from baseline at Week 12-, Endoscopic response (defined as ≥50% SES-CD reduction from baseline) or for a induction baseline SES-CD of 4, at least a 2 point reduction from induction baseline) at Week 12, Endoscopic response (defined as ≥50% SES-CD reduction from baseline), or for a induction baseline SES-CD of 4, at least a 2 point reduction from induction baseline) at Week 48, Endoscopic remission (defined as SES-CD score of ≤2) at week 12, Endoscopic remission (defined as SES-CD score of ≤2) at week 48, Biological remission, defined as C-reactive protein (CRP) <5 mg/L and faecal calprotectin (FCP) < 250 ug/g at week 12, Biological remission, defined as CRP < 5 mg/L and FCP <250 ug/g at week 48, Clinical remission at week 12, defined as a Crohn's Disease Activity Index (CDAI) score of <150, Clinical remission at week 48, defined as a CDAI score of<150, Clinical response at week 12, defined by a CDAI reduction from baseline of at least 100 points, or a CDAI score of <150, Number of patients with treatment-emergent adverse event (TEAE) through end of treatment (EoT) and the residual effect period (REP) (i.e. through Visit 9)

Source: https://euclinicaltrials.eu/ctis-public/view/2024-512756-38-00